EU clinical trial 2022-500967-11-00: A Phase 3, Randomized, Open-label, Study of Subcutaneous Nivolumab + Relatlimab Fixed-dose Combination versus Intravenous Nivolumab + Relatlimab Fixed-dose Combination in Participants with Previously Untreated Metastatic or Unresectable Melanoma
Protocol code: CA224-127
Sponsor: Bristol-Myers Squibb Services Unlimited Company (Pharmaceutical company). Phase: Therapeutic confirmatory (Phase III). Countries: Czechia (ongoing, recruiting), Germany (ongoing, recruiting), Belgium (ongoing, recruiting), Spain (ongoing, recruiting), Austria (ongoing, recruiting), Italy (ongoing, recruiting), Finland (ongoing, recruiting), France (ongoing, recruiting), Sweden (ongoing, recruiting), Norway (ongoing, recruiting), Poland (ongoing, recruiting).
Therapeutic area(s): Diseases [C] - Neoplasms [C04]
Gender: Female, Male. Age: 0-17 years, 18-64 years, 65+ years. Enrolment: 423.
Status: Ongoing, recruiting. Start date (EU): 2023-07-06. Decision date: 2023-03-14. Results received: No. Last updated: 2026-02-17.
Decision dates by country: ES: 2023-03-17, FR: 2023-05-30, NO: 2023-07-10, AT: 2023-08-21, PL: 2023-07-03, SE: 2023-06-05, DE: 2023-03-17, CZ: 2023-03-15, FI: 2023-07-06, BE: 2023-03-14, IT: 2023-03-17

Condition(s): Previously Untreated Metastatic or Unresectable Melanoma
Product: Nivolumab/Relatlimab, FDC Nivolumab + Relatlimab + rHuPH20 Injection

Primary endpoint: Co-Primary: The amount of study drug in your body when given SC is not worse than IV for both nivolumab and relatlimab.
Endpoint(s): Secondary: Percentage of participants whose disease (skin cancer) decreased (Partial response – PR) and/or disappeared (Complete response – CR) after treatment when given under the skin is not worse as compared to given into the vein.

Source: https://euclinicaltrials.eu/ctis-public/view/2022-500967-11-00